EU clinical trial 2025-522778-34-00: The use of intranasal dexmedetomidine for pediatric sedation in non-invasive radiological procedures (CTMS 004321) Assessing the efficacy and safety profile of intranasal dexmedetomidine for procedural sedation in radiological procedures in children with a prospective exploratory interventional monocentric study in a tertiary center in Antwerp (Belgium)
Sponsor: Universitair Ziekenhuis Antwerpen (Hospital/Clinic/Other health care facility). Phase: Therapeutic exploratory (Phase II). Countries: Belgium (authorised, recruitment pending).
Therapeutic area(s): Analytical, Diagnostic and Therapeutic Techniques and Equipment [E] - Anesthesia and Analgesia [E03]
Gender: Female, Male. Age: 0-17 years. Enrolment: 100.
Status: Authorised, recruitment pending. Decision date: 2025-11-07. Results received: No. Last updated: 2025-11-07.

Condition(s): Sedation in healthy children
Product: Dexmedetomidine 100 micrograms/ml concentrate for solution for infusion

Primary endpoint: Success rate after one dose of intranasal dexmedetomidine
Endpoint(s): Success rate after an additional dose of intranasal dexmedetomidine (when adequate sedation is not reached after the first dose), Time to the onset of sedation after the first administration of intranasal dexmedetomidine (minutes), Duration of the sedation (minutes), Duration of the procedure (minutes), Waiting time until procedure (minutes), Total length of hospital stay (minutes), Prevalence of side effects

Source: https://euclinicaltrials.eu/ctis-public/view/2025-522778-34-00